EU clinical trial 2023-507926-18-00: Effect of methylphenidate on cancer-related fatigue in patients treated for a brain tumor during childhood or adolescence: Protocol for a randomized, double-blind, placebo-controlled crossover trial - the EMBRAIN trial
Sponsor: Odense University Hospital (Hospital/Clinic/Other health care facility). Phase: Therapeutic confirmatory (Phase III). Countries: Denmark (ongoing, recruiting).
Therapeutic area(s): Diseases [C] - Neoplasms [C04]
Gender: Female, Male. Age: 0-17 years, 18-64 years. Enrolment: 38.
Status: Ongoing, recruiting. Start date (EU): 2025-09-02. Decision date: 2025-01-18. Results received: No. Last updated: 2026-07-01.

Condition(s): Cancer-related fatigue after treatment of pediatric brain tumor
Product: METHYLPHENIDATE, PLACEBO

Primary endpoint: Changes in patient self-reported or parent proxy-reported fatigue from baseline to week 6 of MPH or placebo treatment as measured by the PedsQL Multidimensional Fatigue Scale (MFS).
Endpoint(s): Changes from baseline in self and parent-reported executive function measured by the BRIEF-2., Changes from baseline in digital measures of sustained attention and executive function., Changes from baseline in standardized neurocognitive measures of processing speed and working memory., Changes from baseline in self and parent-reported measures of Health Related Quality of Life measured by the PedsQL 4.0 Generic Core Scales Module., Time spent within different activity domains and sleep-wake patterns measured by actigraphy., Changes from baseline in self and parent-reported side-effects measured by Barkley’s Side-Effects Rating Scale.

Source: https://euclinicaltrials.eu/ctis-public/view/2023-507926-18-00